EU clinical trial 2024-514013-34-00: Unravelling the invisiBle infiltRating cOmponeNT Of glioblaStomA Using mRi USpio (BRONTOSAURUS)
Sponsor: Stichting Radboud universitair medisch centrum (Hospital/Clinic/Other health care facility). Phase: Therapeutic use (Phase IV). Countries: Netherlands (authorised, recruitment pending).
Therapeutic area(s): Diseases [C] - Neoplasms [C04]
Gender: Female, Male. Age: 18-64 years, 65+ years. Enrolment: 15.
Status: Authorised, recruitment pending. Decision date: 2024-12-02. Results received: No. Last updated: 2024-12-02.

Condition(s): Glioblastoma
Product: IRON OXIDE (E172)

Primary endpoint: To investigate the dosage of USPIO administration for adequate neuro-imaging (e.g. signal to noise ratio optimization), 6 healthy participants will be included. Obtained images will be reviewed by a panel of radiologists to asses quality and diagnostic performance.
Endpoint(s): Perform MR imaging of glioblastoma by use of a new Off Road multi-sequence protocol (i.e., T1w, T2w, FLAIR, DWI/DTI, SWI, QSM, T1w- and T2*w post-USPIO images) in 15 GBM patients.

Source: https://euclinicaltrials.eu/ctis-public/view/2024-514013-34-00